EU clinical trial 2024-517047-30-01: PSEUDOVAX – A CANCER VACCINE TARGETING MUTATED GNAS COMBINED WITH IMMUNE CHECKPOINT INHIBITION FOR PATIENTS WITH PSEUDOMYXOMA PERITONEI
Protocol code: Pseudovax 1
Sponsor: Oslo University Hospital HF (Hospital/Clinic/Other health care facility). Phase: Human Pharmacology (Phase I)- First administration to humans. Countries: Norway (ongoing, recruiting).
Therapeutic area(s): Diseases [C] - Neoplasms [C04]; Diseases [C] - Pathological Conditions, Signs and Symptoms [C23]
Gender: Female, Male. Age: 18-64 years, 65+ years. Enrolment: 10.
Status: Ongoing, recruiting. Start date (EU): 2025-09-01. Decision date: 2025-09-01. Results received: No. Last updated: 2026-03-19.

Condition(s): Pseudomyxoma Peritonei
Product: Pseudovax, Molgramostim, Tislelizumab, SARGRAMOSTIM

Primary endpoint: Incidence (rate) of IMP-related adverse events, T cell responses against the vaccine peptide in blood samples and skin
Endpoint(s): Progression-free survival, measured as the number of months from date of first treatment until disease progression or death from any cause

Source: https://euclinicaltrials.eu/ctis-public/view/2024-517047-30-01